EU clinical trial 2023-510361-97-00: A Randomized, Double-blind, Placebo-controlled Phase 3 Study of Tamibarotene Plus Azacitidine Versus Placebo Plus Azacitidine in Newly Diagnosed Adult Patients Selected for RARA-positive Higher-risk Myelodysplastic Syndrome
Protocol code: SY-1425-301
Sponsor: Syros Pharmaceuticals Inc. (Pharmaceutical company). Phase: Therapeutic confirmatory (Phase III). Countries: Austria (ended), Poland (ended), Czechia (ended), Belgium (ended), Germany (ended), Spain (ended), France (ended), Hungary (ended), Italy (ended).
Therapeutic area(s): Diseases [C] - Hemic and Lymphatic Diseases [C15]
Gender: Female, Male. Age: 18-64 years, 65+ years. Enrolment: 417.
Status: Ended. End date (EU): 2024-11-12. Decision date: 2024-06-06. Results received: No. Last updated: 2024-11-27.
Decision dates by country: AT: 2024-06-11, BE: 2024-06-07, CZ: 2024-06-10, DE: 2024-06-11, HU: 2024-06-06, ES: 2024-06-10, PL: 2024-06-10, IT: 2024-06-11, FR: 2024-06-07

Condition(s): Newly Diagnosed RARA-positive Adult Patients with Higher-risk Myelodysplastic Syndrome
Product: Azacitidin Zentiva 25 mg/ml Pulver zur Herstellung einer Injektionssuspension, Azacitidine 25 mg/mL powder for suspension for injection, SY-1425, Placebo for Tamibarotene (SY-1425), AZACITIDINE

Primary endpoint: Complete remission/complete response rate as determined by the investigator per the modified IWG MDS criteria.
Endpoint(s): Overall survival (OS), defined as the time from the date of randomization to the date of death due to any cause;, Transfusion independence (TI), defined as a period of at least 56 days with no RBC or platelet transfusion since the date of randomization to the last dose of study drug +30 days, the initiation of post-treatment therapy, or death, whichever occurs first, Overall response, defined as achieving complete remission/complete response (CR), partial remission/partial response (PR), marrow complete remission/complete response (mCR), or hematologic improvement (HI) as determined by the investigator per the modified IWG MDS criteria, Duration of complete response, defined as the duration from the date of first documented evidence of complete remission/complete response to the date of documented relapse of disease as determined by the investigator per the modified IWG MDS criteria, or death due to any cause, whichever occurs first, Duration of overall response defined as the duration from the date of first documented evidence of complete remission/complete response, partial remission/partial response, marrow complete remission/complete response, or hematologic improvement to the date of documented disease progression, relapse of disease as determined by the investigator per the modified IWG MDS criteria, or death due to any cause, whichever occurs first, Time to complete remission/complete response, defined as the duration from the date of randomization to the date of the first documented evidence of complete remission/complete response as determined by the investigator per the modified IWG MDS criteria, Time to initial response, defined as the duration from the date of randomization to the date of the first documented evidence of complete remission/complete response, partial remission/partial response, marrow complete remission/complete response, or hematologic improvement as determined by the investigator per the modified IWG MDS criteria, Event-free survival (EFS), defined as the time from the date of randomization to the date of transformation to AML or death due to any cause, whichever occurs first, Change in Health-related quality of life (HRQOL) as measured by the EORTC QLQ-30 and EQ-5D-5L, Adverse events and changes in clinical laboratory values, electrocardiogram results, and vital sign measurements

Source: https://euclinicaltrials.eu/ctis-public/view/2023-510361-97-00